EU clinical trial 2025-522235-34-00: Low Intervention, Open, Multicentric, Phase IV Exploratory Clinical Trial to evaluate new biomarkers for the diagnosis and treatment monitoring of tuberculosis
Protocol code: BIOMARK4TB
Sponsor: Fundacion Para La Investigacion Biomedica Del Hospital Universitario La Paz (Patient organisation/association). Phase: Therapeutic use (Phase IV). Countries: Spain (ongoing, recruiting).
Therapeutic area(s): Diseases [C] - Bacterial Infections and Mycoses [C01]
Gender: Female, Male. Age: 18-64 years, 65+ years. Enrolment: 75.
Status: Ongoing, recruiting. Start date (EU): 2026-02-11. Decision date: 2025-09-09. Results received: No. Last updated: 2026-08-03.

Condition(s): Bacterial pneumonia patients, Pulmonary tuberculosis patients
Product: Rifinah 300 mg/150 mg comprimidos recubiertos con película, Rimstar comprimidos recubiertos con película

Primary endpoint: Diagnostic accuracy (sensitivity and specificity) of the MBLA and RS-Ratio levels measured in blood samples to detect active pulmonary tuberculosis compared to non-TB controls (Arm B patients), based on reference standards (sputum culture or GeneXpert results)., Correlation between the evolution of longitudinal changes of the MBLA and RS-Ratio levels measured in blood samples and established indicators of pulmonary tuberculosis progression (quantitative bacterial load measured by serial sputum culture or molecular assays, radiological findings or clinical progression indicators, whichever is available).
Endpoint(s): Correlation between the evolution of PET/MRI imaging patterns in early and late-stage pulmonary tuberculosis and the evolution of PET/MRI imaging patterns in bacterial pneumonia., Correlation between the evolution of PET/MRI imaging patterns in early and late-stage pulmonary tuberculosis and established indicators of pulmonary tuberculosis progression (quantitative bacterial load measured by serial sputum culture or molecular assays or clinical progression indicators, whichever is available)., Correlation between MBLA/RS-Ratio levels measured by droplet digital polymerase chain reaction (ddPCR) in blood and MBLA/RS-Ratio levels measured in sputum samples., Diagnostic accuracy (sensitivity and specificity) of the MBLA and RS-Ratio levels measured in sputum samples to detect active pulmonary tuberculosis compared to non-TB controls (Arm B patients), based on reference standards (sputum culture or GeneXpert results)., Correlation between the evolution of longitudinal changes of the MBLA and RS-Ratio levels measured in sputum samples and established indicators of pulmonary tuberculosis progression (quantitative bacterial load measured by serial sputum culture or molecular assays, radiological findings or clinical progression indicators, whichever is available)., Diagnostic accuracy (sensitivity and specificity) of several immune molecules’ (refer to Section 13.2: Appendix 2: Laboratory Tests for the complete list of immunological molecules analyzed) levels to detect active pulmonary tuberculosis compared to non-TB controls (Arm B patients), based on reference standards (sputum culture or GeneXpert results)., Correlation between the evolution of longitudinal changes of several immune molecules’ (refer to Section 13.2: Appendix 2: Laboratory Tests for the complete list of immunological molecules analyzed) levels and established indicators of pulmonary tuberculosis progression (quantitative bacterial load measured by serial sputum culture or molecular assays, radiological findings or clinical progression indicators, whichever is available)., Correlation between the evolution of longitudinal changes of the MBLA and RS-Ratio levels measured in blood samples and the standard regimen anti-tuberculosis drugs’ pharmacokinetic profile., Correlation between the evolution of longitudinal changes of the MBLA and RS-Ratio levels measured in sputum samples and the standard regimen anti-tuberculosis drugs’ pharmacokinetic profile., Correlation between the evolution of longitudinal changes of the MBLA and RS-Ratio levels measured both in blood and in sputum, the evolution of the studied immune related molecules’ levels and the evolution of PET/MRI imaging patterns throughout the course of pulmonary tuberculosis infection.

Source: https://euclinicaltrials.eu/ctis-public/view/2025-522235-34-00